EU clinical trial 2023-509551-14-00: Randomized phase 3 study of intermittent or continuous Panitumumab plus FOLFIRI for first-line treatment of patients with unresectable left sided RAS/B-RAF wild-type metastatic colorectal cancer (IMPROVE-2 trial)
Sponsor: IRCCS Istituto Nazionale Tumori Fondazione Pascale (Hospital/Clinic/Other health care facility). Phase: Therapeutic confirmatory (Phase III). Countries: Italy (ongoing, recruiting).
Therapeutic area(s): Diseases [C] - Neoplasms [C04]; Analytical, Diagnostic and Therapeutic Techniques and Equipment [E] - Therapeutics [E02]; Diseases [C] - Digestive System Diseases [C06]
Gender: Female, Male. Age: 18-64 years, 65+ years. Enrolment: 500.
Status: Ongoing, recruiting. Start date (EU): 2024-06-12. Decision date: 2024-04-17. Results received: No. Last updated: 2026-03-06.

Condition(s): Unresectable left sided RAS/B-RAF wild-type metastatic colorectal cancer
Product: Vectibix 20 mg/ml concentrate for solution for infusion

Primary endpoint: Time to Treatment Failure (TTF) between the two arms: TTF is defined as the time from randomization to the objective disease progression by RECIST 1.1 criteria occurred during the treatment (objective disease progression during treatment free intervals are excluded) or death due to any cause, whichever occurs first, or a treatment delay > 28 days for toxicity
Endpoint(s): Objective Tumor Response Rate (ORR) assessed according to RECIST criteria 1.1, Disease Control Rate (DCR) defined as the proportion of patients with complete/partial response and stable disease as their best response., Depth of response (DpR) assessed as the percentage of tumor shrinkage observed at the lowest point (nadir) compared with baseline., Progression-free survival (PFS) measured as the time from the date of randomization until the date of the first observation of disease progression or death due to any cause, whichever occurs first., Progression-free survival on treatment (PFSot) measured as the time from the date of randomization to the date of disease progression occurred during treatment or death due to any cause, whichever occurs first., Overall survival (OS) calculated as the time from the date of randomization until the date of death from any cause., Safety evaluated as adverse events graded according NCI CTCAE v 5.0., Tolerability evaluated as longitudinal toxicity over time and adverse event burden score., Time toxicity measured as hospital-free days, Quality of life (QoL) investigated through the EORTC QLQ-C30 and CR29 questionnaires-, Patient Report Outcome (PRO)-CTCAE with items dedicated in particular to diarrhea and skin toxicity to evaluate the effect of the treatment on the health-related QoL, We will also explore the prognostic and predictive value of next generation sequencing (NGS), from blood samples (“liquid biopsy”) collected at baseline, at week 16 and thereafter every 8 weeks and serum metabolomic profiling in peripheral blood evaluated by NMR Spectrometer (600 MHz) concomitantly with tumor assessment, and at progression of disease. as well as the potential to monitor treatment activity of at baseline and during treatment.

Source: https://euclinicaltrials.eu/ctis-public/view/2023-509551-14-00